EU clinical trial 2023-504484-16-00: CO43923 Master Protocol: A Platform Study Evaluating the Safety and Efficacy of Multiple Treatments in Patients with Multiple Myeloma CO43923 Substudy 1: A Non-Interventional Study to Collect Patient-Level Data in Patients with Multiple Myeloma CO43923 Substudy 2 Cevos + Len Treatment: A Phase Ib, Single Arm, Open-Label Study Evaluating the Safety and Efficacy of Cevostamab in Combination with Lenalidomide in Patients with Cytogenetic High-Risk Features Receiving Maintenance Treatment After First Response from Multiple Myeloma Post-Stem Cell Transplant CO43923 Substudy 4 Cevostamab+ Iberdomide Treatment: A Phase Ib, Single Arm, Open-Label Study Evaluating the Safety, Tolerability, Pharmacokinetics, and Pharmacodynamics of Cevostamab in Combination with Iberdomide in Patients with Relapsed or Refractory Multiple Myeloma
Protocol code: CO43923
Sponsor: F. Hoffmann-La Roche AG (Pharmaceutical company). Phase: Phase I and Phase II (Integrated)- Other. Countries: Germany (ongoing, recruiting), France (ongoing, recruiting), Poland (ongoing, recruiting), Spain (ongoing, recruiting).
Therapeutic area(s): Diseases [C] - Neoplasms [C04]
Gender: Female, Male. Age: 18-64 years, 65+ years. Enrolment: 32.
Status: Ongoing, recruiting. Start date (EU): 2022-11-18. Decision date: 2024-07-23. Results received: No. Last updated: 2026-03-13.
Decision dates by country: DE: 2024-07-26, PL: 2024-07-29, ES: 2024-07-23, FR: 2024-07-26

Condition(s): Multiple Myeloma (MM)
Product: Iberdomide, Iberdomide, Cevostamab, Iberdomide, Revlimid 10 mg hard capsules, RoActemra 20 mg/mL concentrate for solution for infusion, Iberdomide, Revlimid 5 mg hard capsules

Primary endpoint: 1. Stage 1: Incidence and severity of adverse events, including dose-limiting toxicities (DLTs), with severity determined according to National Cancer Institute Common Terminology Criteria for Adverse Events, Version 5.0 (NCI CTCAE v5.0); for cytokine release syndrome (CRS) and immune effector cell-associated neurotoxicity syndrome(ICANS), severity is determined according to respective American Society for Transplantation and Cellular Therapy (ASTCT) Consensus Grading Scales, 2. Stage 2: ORR, defined as the proportion of patients with a stringent complete response (sCR), CR, very good partial response (VGPR), or partial response (PR), 3. Stage 2: Rate of CR or sCR, defined as proportion of patients achieving a CR or sCR, 4. Stage 2: Rate of VGPR or better, defined as the proportion of patients achieving a VGPR or better, 5. Stage 2: PFS, defined as the time from initiation of study treatment to the first occurrence of progressive disease or death from any cause (whichever occurs first), 6. Stage 2: OS, defined as the time from initiation of study treatment to death from any cause
Endpoint(s): 1. Stage 1 (maintenance substudies): Conversion to a better response (e.g., from PR to VGPR or better; or from VGPR to CR/sCR or from CR to sCR), 2. Stage 1 (maintenance substudies): PFS, defined as the time from initiation of study treatment to the first occurrence of progressive disease or death from any cause (whichever occurs first), 3. Stage 1 (maintenance substudies): OS, defined as the time from initiation of study treatment to death from any cause, 4. Stage 1 (maintenance substudies): MRD negativity rate, defined as proportion of patients who are MRD negative at any time by next-generation sequencing (NGS) on bone marrow aspirate, 5. Stage 1 (all other substudies): ORR, defined as the proportion of patients with a sCR, CR, VGPR, or PR, 6. Stage 1 (all other substudies): Rate of CR or sCR, defined as proportion of patients achieving a CR or sCR, 7. Stage 1 (all other substudies): Rate of VGPR or better, defined as the proportion of patients achieving a VGPR or better, 8. Stage 1 (all other substudies): PFS, defined as the time from initiation of study treatment to the first occurrence of progressive disease or death from any cause (whichever occurs first), 9. CO43271 Stage 1 (all other substudies): DOR, defined as the time from the first documented objective response until disease progression or death from any cause, (whichever occurs first), 10. Stage 1 (all other substudies): OS, defined as the time from initiation of study treatment to death from any cause, 11. Stage 1 (all other substudies): MRD negativity rate, defined as proportion of patients who are MRD negative at any time by NGS on bone marrow aspirate, 12. Stage 1 (all other substudies): Time to first response (for patients who achieve a response of PR or better), defined as time from initiation of study treatment to first achieving a PR or better, 13. Stage 1 (all other substudies): Time to best response (for patients who achieve a response of PR or better), defined as time from initiation of study treatment to achieving the deepest response, 14. Stage 2: DOR, defined as the time from the first documented objective response until disease progression or death from any cause (whichever occurs first), 15. Stage 2: Time to first response (for patients who achieve a response of PR or better), defined as time from initiation of study treatment to achieving a PR or better, 16. Stage 2: Time to best response (for patients who achieve a response of PR or better), defined as time from initiation of study treatment to achieving the deepest response, 17. Stage 2: MRD negativity rate, defined as proportion of patients who are MRD negative by NGS on bone marrow aspirate, 18. Stage 2: Incidence and severity of adverse events, including DLTs, with severity determined according to NCI CTCAE v5.0; for CRS and ICANS, severity is determined according to ASTCT Consensus Grading Scales

Source: https://euclinicaltrials.eu/ctis-public/view/2023-504484-16-00